EU clinical trial 2024-512408-20-00: A randomized controlled trial with Rituximab for Psychotic disorder in adults
Protocol code: RCT-RITS
Sponsor: Region Oerebro Laen (Hospital/Clinic/Other health care facility). Phase: Therapeutic exploratory (Phase II). Countries: Sweden (ended).
Therapeutic area(s): Psychiatry and Psychology [F] - Mental Disorders [F03]
Gender: Female, Male. Age: 18-64 years. Enrolment: 120.
Status: Ended. Start date (EU): 2024-08-27. End date (EU): 2026-08-04. Decision date: 2024-08-27. Results received: No. Last updated: 2024-12-11.

Condition(s): Schizophrenia spectrum disorder (SSD)
Product: RITUXIMAB

Primary endpoint: Positive and Negative Syndrome Scale (PANSS) is a measure for severity in patients with schizophrenia (Kay et al. 1987). It is widely used in the study of antipsychotic therapy and is known as the “gold standard” for the assessment of schizophrenia. To assess a patient using PANSS, an approximately 45-minute clinical interview is conducted. The patient is rated from 1 to 7 on 30 different symptoms based on the interview as well as reports from family members or caretaking healthcare workers..., ... The time span considered is the week before the rating. Seven items measure “positive” symptoms, 7 items “negative” symptoms, and 16 items general psychopathology. Each item is graded between 1 and 7 resulting in a total score between 30 which correspond to no symptoms and a maximum of 210 points. We will evaluate the item A6 for depression separately at baseline and endpoints in order to assess depressive symptoms.
Endpoint(s): Personal and Social Performance Scale (PSP) (Morosini et al., 2000) is a 100-point single-item rating scale, subdivided into 10 equal intervals. The ratings are based on the assessment of patient’s functioning in four main areas: 1) socially useful activities, 2) personal and social relationships, 3) self-care, and 4) disturbing and aggressive behaviors. In responders, we expect a 25 % reduction or more in the PSP score., Clinical Global Impression-Improvement scale (CGI-I) measures change of symptoms on a 7-point Likert scale. CGI-I will also be administered to the next-of-kin. In both the clinical and next-of-kin assessment, clinical response in this study is regarded as a score of 1 or 2 corresponding to very much improved or much improved. Investigators may score CGI-I into half points, but those will be transformed into whole numbers in the analyses of the data., Clinical Global Impression-Severity scale (CGI-S) is a clinician rated measure of overall clinical severity in the context of the diagnostic group. A person with no clinical complaints or problems will get a score of 1. The score 7, which indicates the highest level of severity is phrased as “Among the most extremely ill patients”., Positive and Negative Syndrome Scale (PANSS) is a measure for severity in patients with schizophrenia. Improvements will be calculated by reducing the baseline scores with 30 points (which equals no symptoms) to reach a PANSS 0 score., VAS-health is a patient self-evaluated health measure using a horizontal visual analogue scale ranging from 0 (= worst imaginable health) to 100 (= best imaginable health) the day of the visit. A 25 % reduction from baseline will be regarded as a self-reported treatment response measure., Patient’s Global Evaluation (PGE) provides a self-administered global measure of improvement on a 7-point Likert scale identical to the CGI-I scoring system. In this study minimal improvement, i.e. a score of 3 (or below) is regarded as treatment response as individuals with SSD frequently tend to lack ability to observe improvements., Baseline levels of inflammatory markers in relation to treatment response (i.e. a PANSS reduction of 30% or more) will be examined at both endpoints. Change in inflammatory markers in relation to response will also be investigated. Severity and frequencies of adverse events according to Any Adverse Reactions-Revised (AAR-R)., Severity and frequencies of adverse events according to Any Adverse Reactions-Revised (AAR-R)., Change in brain activity (e.g. blood flow and Default mode network) and morphology before and after treatment and in relation to response., Level 1 Cross-cutting symptom measure of global symptom severity (APA, 2013) is a patient rated measure included in the DSM-5, which assesses mental health domains that are important across psychiatric diagnoses. It includes 13 domains and each of the items are rated 0-4 on a Likert scale. We will investigate if each endorsed domain is associated with response.

Source: https://euclinicaltrials.eu/ctis-public/view/2024-512408-20-00